EU clinical trial 2024-518771-66-00: LIGHTBEAM-U01 Substudy 01C: A Phase 1/2 Substudy to Evaluate the Safety and Efficacy of Patritumab Deruxtecan in Pediatric Participants With Relapsed or Refractory Solid Tumors
Protocol code: MK-9999-01C
Sponsor: Merck Sharp & Dohme LLC (Pharmaceutical company). Phase: Phase I and Phase II (Integrated)- Other. Countries: Sweden (ongoing, recruiting), France (ongoing, recruiting), Germany (authorised, recruiting), Spain (ongoing, recruiting), Belgium (ongoing, recruiting), Czechia (ongoing, recruiting), Denmark (authorised, recruiting), Greece (authorised, recruiting), Hungary (ongoing, recruiting), Italy (ongoing, recruiting), Netherlands (authorised, recruiting), Slovakia (authorised, recruiting).
Therapeutic area(s): Diseases [C] - Neoplasms [C04]
Gender: Female, Male. Age: 0-17 years. Enrolment: 32.
Start date (EU): 2025-07-01. Decision date: 2025-06-03. Results received: No. Last updated: 2026-06-05.
Decision dates by country: SE: 2025-06-09, HU: 2025-09-08, NL: 2025-09-08, SK: 2025-09-22, GR: 2025-09-16, IT: 2025-09-17, BE: 2025-08-22, CZ: 2025-09-15, DK: 2025-09-09, FR: 2025-06-03, DE: 2025-06-06, ES: 2025-06-27

Condition(s): Hepatoblastoma, Rhabdomyosarcoma
Product: DEXAMETHASONE, MK-1022

Primary endpoint: Part 1: Percentage of Participants Who Experience Dose-limiting Toxicities (DLTs), Part 1: Percentage of Participants Who Experience an Adverse Event (AE), Part 1: Percentage of Participants Who Discontinue Study Treatment Due to an AE, Part 1: Area Under the Curve (AUC) of total anti-HER3 antibody liquid chromatography-mass spectrometry (LC-MS) in plasma, Part 1: AUC of anti-HER3 antibody-conjugated DXd (anti-HER3-ac-DXd) in plasma, Part 1: AUC of DXd in plasma, Part 1: Maximum Concentration (Cmax) of anti-HER3 antibody LC-MS in plasma, Part 1: Cmax of anti-HER3-ac-DXd in plasma, Part 1: Cmax of DXd in plasma, Part 1: Concentration Immediately Before the Next Dose is Administered (Ctrough) of anti-HER3 antibody LC-MS in plasma, Part 1: Ctrough of anti-HER3-ac-DXd, Part 1: Ctrough of DXd in plasma, Part 1 and Part 2: Objective Response Rate (ORR)
Endpoint(s): Part 2: Percentage of Participants Who Experience an AE, Part 2: Percentage of Participants Who Discontinue Study Treatment Due to an AE, Part 1 and Part 2: Disease Control Rate (DCR), Part 1 and Part 2: Time to Response (TTR), Part 1 and Part 2: Duration of Response (DOR), Part 1 and Part 2: Progressive-free Survival (PFS), Part 1 and Part 2: Overall Survival (OS), Part 2: AUC of total anti-HER3 antibody LC-MS in plasma, Part 2: AUC of anti-HER3-ac-DXd in plasma, Part 2: AUC of DXd in plasma, Part 2: Cmax of anti-HER3 antibody LC-MS in plasma, Part 2: Cmax of anti-HER3-ac-DXd in plasma, Part 2: Cmax of DXd in plasma, Part 2: Ctrough of anti-HER3 antibody LC-MS in plasma, Part 2: Ctrough of anti-HER3-ac-DXd in plasma, Part 2: Ctrough of DXd in plasma

Source: https://euclinicaltrials.eu/ctis-public/view/2024-518771-66-00